EU clinical trial 2025-522090-11-00: A Phase 1b/2a, Multicenter, Open-label Study to Determine the Recommended Dose and Schedule, and Evaluate the Safety and Preliminary Efficacy of Mezigdomide in Combination with Elranatamab in Participants with Relapsed and/or Refractory Multiple Myeloma
Protocol code: CA057-1040
Sponsor: Celgene Corp. (Pharmaceutical company). Phase: Phase I and Phase II (Integrated)- Other. Countries: Norway (authorised, recruiting), Greece (ongoing, recruiting), Germany (ongoing, recruiting), Spain (ongoing, recruiting).
Therapeutic area(s): Diseases [C] - Neoplasms [C04]
Gender: Female, Male. Age: 18-64 years, 65+ years. Enrolment: 24.
Start date (EU): 2026-01-22. Decision date: 2025-10-21. Results received: No. Last updated: 2026-06-12.
Decision dates by country: ES: 2025-10-23, GR: 2025-10-21, NO: 2025-10-22, DE: 2025-10-27

Condition(s): Relapsed or Refractory Multiple Myeloma (RRMM)
Product: CC-92480, CC-92480, CC-92480, CC-92480, ELRANATAMAB, DEXAMETHASONE, CC-92480, CC-92480

Primary endpoint: The main endpoints include the type, frequency, seriousness, and severity of all aAEs., Establish the RP2D and dosing schedule of mezigdomide in combination with elranatamab.
Endpoint(s): The secondary endpoints relate to the effectiveness of the treatment. Specific metrics to be examined include the percentage of participants who respond to treatment (overall response rate; ORR), the percentage of participants who have a very good partial response or better, The percentage of participants who have a very good partial response or better (VGPRR) or complete response or better (CRR) as well as additional measures of response including the time to response (TTR; how long it takes for the treatment to start working), duration of response (DOR; how long the response lasts), progression free survival (PFS; how long it takes for the disease to get worse), and overall survival (OS; how long participants stay alive after receiving the treatment, Number of participants who do not have detectable disease in the body with a sensitive laboratory test. This is called minimum residual disease negativity rate.

Source: https://euclinicaltrials.eu/ctis-public/view/2025-522090-11-00